EU clinical trial 2025-521921-34-00: A study investigating the safety of RO7795074, a new compound that may potentially be used in the treatment of type 1 diabetes, and the effect of RO7795074 on how the body processes pitavastatin
Protocol code: BP45863
Sponsor: Genentech Inc. (Pharmaceutical company). Phase: Human Pharmacology (Phase I)- Other. Countries: Netherlands (ended).
Therapeutic area(s): Diseases [C] - Nutritional and Metabolic Diseases [C18]
Gender: Female, Male. Age: 18-64 years. Enrolment: 32.
Status: Ended. Start date (EU): 2025-12-19. End date (EU): 2026-05-13. Decision date: 2025-12-01. Results received: No. Last updated: 2026-01-12.
Decision dates by country: NL: 2025-12-18

Condition(s): Overweight or Obese (otherwise healthy)

Source: https://euclinicaltrials.eu/ctis-public/view/2025-521921-34-00